EU clinical trial 2023-503602-37-00: Effect at 3 months of early empagliflozin initiation in cardiogenic shock patients on mortality, rehospitalization, left ventricular ejection fraction and renal function. A randomized multicentric open trial. (EMPASHOCK)
Protocol code: 2021PI218
Sponsor: CHRU De Nancy (Hospital/Clinic/Other health care facility). Phase: Therapeutic confirmatory (Phase III). Countries: France (ongoing, recruiting).
Therapeutic area(s): Diseases [C] - Cardiovascular Diseases [C14]
Gender: Female, Male. Age: 18-64 years, 65+ years. Enrolment: 164.
Status: Ongoing, recruiting. Start date (EU): 2024-12-16. Decision date: 2024-04-09. Results received: No. Last updated: 2025-11-27.

Condition(s): Cardiogenic Shock
Product: Jardiance 10 mg film-coated tablets

Primary endpoint: Hierarchical composite endpoint, assessed at 12 weeks from randomization (win-ratio method): - Rank 1: time to all-cause death or heart transplant or mechanical ventricular assist. - Rank 2: time to rehospitalization for heart failure - Rank 3: left ventricular ejection fraction assessed by echocardiography
Endpoint(s): Death at 12 weeks, Heart transplantation or long-term ventricular assistance at 12 weeks, Rehospitalization for heart failure from hospital discharge to 12-week, Left ventricular ejection fraction at 12 weeks, Left ventricular relaxation and filling pressures assessed at 12 weeks: e' wave, E/e' ratio,, Right ventricular function assessed at 12 weeks: TAPSE, S wave, Number of patients requiring extra-renal purification between randomization and 12 weeks, and evolution of renal function assessed at randomization and at 12 weeks: glomerular filtration rate calculated by the CKD-EPI method, Liver function assessed at randomization and at 12 weeks: Bilirubin, Prothrombin Ratio , SGOT, SGPT., Weight and NT-proBNP (at randomization and at 12 weeks).

Source: https://euclinicaltrials.eu/ctis-public/view/2023-503602-37-00